EU clinical trial 2023-507338-26-00: A Randomized, Double-blind, Placebo-controlled, Phase III Study of Neoadjuvant-Adjuvant Durvalumab and FLOT Chemotherapy Followed by Adjuvant Durvalumab in Patients with Resectable Gastric and Gastroesophageal Junction Cancer (GC/GEJC) (MATTERHORN)
Protocol code: D910GC00001
Sponsor: Astrazeneca AB (Pharmaceutical company). Phase: Therapeutic confirmatory (Phase III). Countries: France (ongoing, recruitment ended), Poland (ongoing, recruitment ended), Hungary (ongoing, recruitment ended), Germany (ongoing, recruitment ended), Belgium (ongoing, recruitment ended), Denmark (ongoing, recruitment ended), Spain (ongoing, recruitment ended), Netherlands (ongoing, recruitment ended).
Therapeutic area(s): Diseases [C] - Neoplasms [C04]
Gender: Female, Male. Age: 18-64 years, 65+ years. Enrolment: 341.
Status: Ongoing, recruitment ended. Start date (EU): 2021-02-01. Decision date: 2024-01-29. Results received: No. Last updated: 2026-03-11.
Decision dates by country: BE: 2024-01-30, NL: 2024-02-02, DE: 2024-01-29, ES: 2024-01-29, PL: 2024-02-09, HU: 2024-01-31, FR: 2024-01-29, DK: 2024-01-29

Condition(s): Histologically documented gastric or gastroesophageal junction adenocarcinoma with resectable disease (Stage II or higher per AJCC 8th edition).
Product: INFLIXIMAB, FOLINIC ACID, IMFINZI 50 mg/mL concentrate for solution for infusion., DOCETAXEL, PLACEBO, OXALIPLATIN, FLUOROURACIL, MYCOPHENOLATE MOFETIL

Primary endpoint: EFS (event free survival)
Endpoint(s): OS (Overall Survival), pCR rate

Source: https://euclinicaltrials.eu/ctis-public/view/2023-507338-26-00